EU clinical trial 2025-521868-35-00: A Phase 2a, Multicenter, Randomized, Double-Blind, Placebo-Controlled Study to Assess the Efficacy, Safety, Tolerability, and Pharmacokinetics of NBI-1117570 in Adults with Schizophrenia Who Warrant Inpatient Hospitalization
Protocol code: NBI-1117570-SCZ2035
Sponsor: Neurocrine Biosciences Inc. (Pharmaceutical company). Phase: Therapeutic exploratory (Phase II). Countries: Romania (ongoing, recruiting), Poland (authorised, recruitment pending), Bulgaria (ongoing, recruiting).
Therapeutic area(s): Psychiatry and Psychology [F] - Mental Disorders [F03]
Gender: Female, Male. Age: 18-64 years. Enrolment: 81.
Start date (EU): 2026-04-08. Decision date: 2026-03-23. Results received: No. Last updated: 2026-07-13.
Decision dates by country: PL: 2026-03-23, BG: 2026-03-23, RO: 2026-03-23

Condition(s): Schizophrenia
Product: Placebo for nbi-1117570, NBI-1117570, NBI-1117570

Primary endpoint: Change from baseline in the Positive and Negative Syndrome Scale (PANSS) total score. This scale measures the severity of symptoms in people with schizophrenia.

Source: https://euclinicaltrials.eu/ctis-public/view/2025-521868-35-00